EU clinical trial 2024-511252-41-00: ADOPT; Androgen Deprivation therapy for Oligo-recurrent Prostate cancer in addition to radioTherapy
Protocol code: RT2019-13
Sponsor: Universitair Medisch Centrum Groningen (Hospital/Clinic/Other health care facility). Phase: Therapeutic confirmatory (Phase III). Countries: Netherlands (ongoing, recruitment ended).
Therapeutic area(s): Diseases [C] - Neoplasms [C04]
Gender: Male. Age: 18-64 years, 65+ years. Enrolment: 280.
Status: Ongoing, recruitment ended. Start date (EU): 2024-07-30. Decision date: 2024-07-29. Results received: No. Last updated: 2024-07-29.

Condition(s): Patients with biochemical recurrence after primary treatment of prostate cancer presenting with =<4 metastases
Product: Eligard 22,5 mg poeder en oplosmiddel voor oplossing voor injectie

Primary endpoint: The primary endpoint is the 2-year metastases progression free survival
Endpoint(s): 3 years PSA progression., Start of 2nd line treatment., Start 2nd MDRT treatment for new (progressive) oligometastases., Acute and late toxicity (late toxicity up to 3 years)., Clinical progression-free survival., Quality of life., Progression pattern., Time to start of palliative ADT., Time to castration-resistance., Disease-specific and overall survival., Sensitivity of the imaging modality (PSMA-PET/CT or PSMA-PET/MRI) for patients receiving MDRT., Predictive biomarkers.

Source: https://euclinicaltrials.eu/ctis-public/view/2024-511252-41-00